EU clinical trial 2022-502018-10-00: Patient Walking Rehabilitation Program with osteoarthritis of the hip or knee helped by a one-off anti-inflammatory treatment (pilot cohort study with short walking objectives) - PERIPATEI
Protocol code: RBHP 2022 DUALE
Sponsor: University Hospital Of Clermont-Ferrand (Hospital/Clinic/Other health care facility). Phase: Therapeutic use (Phase IV). Countries: France (ongoing, recruiting).
Therapeutic area(s): Analytical, Diagnostic and Therapeutic Techniques and Equipment [E] - Therapeutics [E02]
Gender: Female, Male. Age: 18-64 years, 65+ years. Enrolment: 55.
Status: Ongoing, recruiting. Start date (EU): 2023-11-07. Decision date: 2023-01-18. Results received: No. Last updated: 2026-01-16.

Condition(s): Idiopathic osteoarthritis of the hip or knee
Product: FLECTOR 50 mg, comprimé, NIFLURIL 250 mg, gélule, DOLIPRANE 1000 mg, comprimé effervescent sécable, IBUPROFENE ARROW 200 mg, comprimé enrobé, LANSOPRAZOLE MYLAN PHARMA 15 mg, gélule gastro-résistante, PROFENID 50 mg, gélule

Primary endpoint: For a given individual, the main criterion is the success of the therapeutic program, defined by an increase of at least 30% in the monthly number of target movements compared to the month of basal observation, in the absence of treatment discontinuation. NSAIDs for intolerance

Source: https://euclinicaltrials.eu/ctis-public/view/2022-502018-10-00